EU clinical trial 2024-511040-58-00: An open-label, multi-center, Phase IV, roll-over study in patients with ALK positive malignancies who have completed a prior Novartis-sponsored ceritinib (LDK378) study and are judged by the investigator to benefit from continued treatment with ceritinib
Protocol code: CLDK378A2X01B
Sponsor: Novartis Pharma AG (Pharmaceutical company). Phase: Therapeutic use (Phase IV). Countries: Belgium (ongoing, recruitment ended), Germany (ongoing, recruitment ended), Poland (ongoing, recruitment ended), Bulgaria (ongoing, recruitment ended), France (ongoing, recruitment ended), Italy (ongoing, recruitment ended).
Therapeutic area(s): Diseases [C] - Neoplasms [C04]
Gender: Female, Male. Age: 0-17 years, 18-64 years, 65+ years. Enrolment: 67.
Status: Ongoing, recruitment ended. Start date (EU): 2016-01-12. Decision date: 2024-06-13. Results received: No. Last updated: 2026-01-22.
Decision dates by country: BE: 2024-06-14, DE: 2024-06-17, IT: 2024-06-18, PL: 2024-06-14, FR: 2024-06-13, BG: 2024-06-13

Condition(s): non small cell lung cancer
Product: CERITINIB

Primary endpoint: Frequency and severity of AEs/SAEs
Endpoint(s): Proportion of patients with clinical benefit as assessed by the investigator at scheduled visits.

Source: https://euclinicaltrials.eu/ctis-public/view/2024-511040-58-00